EU clinical trial 2023-509356-34-00: An Open-label, Phase 2 Study of ACP-196 in Subjects with Waldenström Macroglobulinemia
Protocol code: ACE-WM-001
Sponsor: Acerta Pharma B.V. (Pharmaceutical company). Phase: Therapeutic exploratory (Phase II). Countries: Greece (ongoing, recruitment ended), France (ongoing, recruitment ended), Italy (ongoing, recruitment ended).
Therapeutic area(s): Diseases [C] - Neoplasms [C04]
Gender: Female, Male. Age: 18-64 years, 65+ years. Enrolment: 6.
Status: Ongoing, recruitment ended. Start date (EU): 2015-09-28. Decision date: 2024-08-20. Results received: No. Last updated: 2026-07-29.
Decision dates by country: FR: 2024-08-20, GR: 2024-09-20, IT: 2024-08-20

Condition(s): Waldenström Macroglobulinemia
Product: Calquence 100 mg hard capsules, Calquence 100 mg film-coated tablets

Primary endpoint: ORR, defined as a subject achieving a MR or better according to the response assessment criteria for WM as assessed by the investigator, ORR, defined as a subject achieving a MR or better according to the response assessment criteria defined by modified 3rd IWWM workshop criteria as assessed by the investigator
Endpoint(s): Efficacy: •DOR assessed by the investigator using response assessment criteria for WM and modified 3rd IWWM workshop criteria • PFS assessed by the investigator using response assessment criteria for WM and Modified 3rd IWWM workshop criteria • Overall survival (OS) •Effect of acalabrutinib on peripheral T/B/NK cell counts •Effect of acalabrutinib on serum immunoglobulin levels, Safety: •Frequency, severity, and relatedness of AEs •Frequency of AEs requiring discontinuation of study drug or dose reductions, Pharmacokinetics: •Plasma pharmacokinetics of acalabrutinib, Patient Reported Outcomes (PRO): •Health-related quality of life

Source: https://euclinicaltrials.eu/ctis-public/view/2023-509356-34-00